EU clinical trial 2025-520745-80-00: A randomized controlled trial of two adjunctive host-directed therapies in rifampin-resistant tuberculosis (DRTB-HDT).
Protocol code: AUR1-1-313 DRTB-HDT
Sponsor: The Aurum Institute, Quality Regulatory Clinical Ireland Limited, Quality Regulatory Clinical Ireland Limited (Patient organisation/association, Pharmaceutical company, Pharmaceutical company). Phase: Therapeutic exploratory (Phase II). Countries: Romania (ended).
Therapeutic area(s): Diseases [C] - Respiratory Tract Diseases [C08]
Gender: Female, Male. Age: 18-64 years, 65+ years. Enrolment: 44.
Status: Ended. End date (EU): 2025-10-31. End date: 2025-11-30. Decision date: 2025-01-30. Results received: No. Last updated: 2025-09-15.

Condition(s): Multidrug rezistant pulmonary tuberculosis
Product: Metformin Zentiva 500 mg Filmtabletten

Primary endpoint: To examine the safety, tolerability, and preliminary efficacy of two adjuvant TB-HDT therapies (one anti-inflammatory and one antimicrobial) in patients with rifampicin-resistant pulmonary tuberculosis. Efficacy endpoints will include measures of lung function recovery and eradication of M tuberculosis infection. Time point of assessment for this primary endpoint: month 6 (nominal months of 4 weeks)
Endpoint(s): 1. FEV1 at month 6 2. Probability of stable culture conversion by month 6 Both co-primary endpoints must be met for a treatment to be considered successful. The CC-11050 and Metformin arms will each be compared to the control arm. Time of assessment of this secondary endpoint: Up to 18 months after study entry.

Source: https://euclinicaltrials.eu/ctis-public/view/2025-520745-80-00